EU clinical trial 2022-502713-29-00: A Phase 3, Randomized, Double-Blind, Placebo-Controlled Study to Assess the Efficacy, Safety, and Tolerability of Valbenazine for the Treatment of Dyskinesia Due to Cerebral Palsy
Protocol code: NBI-98854-DCP3018
Sponsor: Neurocrine Biosciences Inc. (Pharmaceutical company). Phase: Therapeutic confirmatory (Phase III). Countries: Portugal (ended), Belgium (ended), Spain (ended), Italy (ended), Poland (ended).
Therapeutic area(s): Diseases [C] - Nervous System Diseases [C10]
Gender: Female, Male. Age: 0-17 years, 18-64 years, 65+ years. Enrolment: 49.
Status: Ended. Start date (EU): 2024-03-01. End date (EU): 2026-03-30. End date: 2026-03-31. Decision date: 2023-10-23. Results received: No. Last updated: 2025-11-05.
Decision dates by country: IT: 2023-10-31, ES: 2023-10-23, PT: 2023-10-25, BE: 2023-11-06, PL: 2023-11-10

Condition(s): Dyskinesia due to cerebral palsy (DCP)
Product: Valbenazine, Matching placebo for valbenazine, Valbenazine, Valbenazine, Valbenazine, Valbenazine, Valbenazine

Primary endpoint: The change in the Total Maximal Chorea (TMC) score of the Unified Huntington Disease Rating Scale (UHDRS) from baseline to the average of the Week 12 and Week 14 assessments
Endpoint(s): The change in Clinical Global Impression of Severity (CGI-S) score from baseline to Week 14, The change in Movement Disorders - Childhood Rating Scale (MD-CRS) Part I score from baseline to the average of the Week 12 and Week 14 assessments, The change in the Total Maximal Dystonia (TMD) score of the UHDRS from baseline to the average of the Week 12 and Week 14 assessment, Patient Global Impression of Improvement (PGI-I) score at Week 14 [ Time Frame: Week 14 ], Caregiver Global Impression of Improvement (CaGI-I) score at Week 14 [ Time Frame: Week 14 ], Clinical Global Impression of Improvement (CGI-I) score at Week 14 [ Time Frame: Week 14 ], Goal attainment score at Week 14 using the Goal Attainment Scale (GAS) [ Time Frame: Week 14 ], Change in pain assessment from baseline to Week 14 using the Faces Pain Scale-Revised (FPS-R) [ Time Frame: Baseline, Week 14 ], Change in the UHDRS Total Motor Score (TMS) from baseline to the average of the Week 12 and Week 14 assessments [ Time Frame: Baseline, Week 12 and Week 14 ]

Source: https://euclinicaltrials.eu/ctis-public/view/2022-502713-29-00